EU clinical trial 2023-510470-13-00: A Phase 2 Randomized, Placebo-controlled, Double-blind, Dose-ranging Study to Evaluate the Efficacy, Safety, and Tolerability of AMG 133 in Adult Subjects With Overweight or Obesity, With or Without Type 2 Diabetes Mellitus.
Protocol code: 20190218
Sponsor: Amgen Inc. (Pharmaceutical company). Phase: Therapeutic exploratory (Phase II). Countries: Germany (ended), Spain (ended), Czechia (ended), Poland (ended), Hungary (ended).
Therapeutic area(s): Diseases [C] - Nutritional and Metabolic Diseases [C18]
Gender: Female, Male. Age: 18-64 years, 65+ years. Enrolment: 135.
Status: Ended. Start date (EU): 2023-03-10. End date (EU): 2025-10-14. End date: 2025-12-16. Decision date: 2024-06-28. Results received: No. Last updated: 2026-01-26.
Decision dates by country: HU: 2024-07-04, PL: 2024-08-06, CZ: 2024-07-03, DE: 2024-07-03, ES: 2024-06-28

Condition(s): Overweight and Obesity
Product: AMG 133, Placebo for AMG 133

Primary endpoint: Percent change from baseline to week 52 in body weight
Endpoint(s): Achieving ≥ 5%, ≥ 10%, ≥ 15%, ≥ 20% reduction in body weight from baseline at week 52 (yes/no), Change from baseline to week 52 in hemoglobin A1c (HbA1c), in fasting serum insulin, in fasting plasma glucose, in Homeostasis Model Assessment for insulin resistance (HOMA2-IR), in Homeostasis Model Assessment for steady state beta cell function (HOMA2-%B), PK parameters for AMG 133 including, but not limited to maximum observed plasma concentration (Cmax), and area under the concentration-time curve (AUC), Change from baseline to week 52 in waist circumference, in body weight, in SBP, in DBP, in BMI, in body composition (eg, fat mass, lean mass) using dual-energy X-ray absorptiometry (DXA) for a subset of subjects, Percent change from baseline to week 52 in high-sensitivity C-reactive protein (hs-CRP), in low-density lipoprotein cholesterol (LDL-C), in total cholesterol, in high-density lipoprotein cholesterol (HDL-C), in non-HDL-C, in very-low-density lipoprotein cholesterol (VLDL-C), in triglycerides, in free fatty acids (FFA)

Source: https://euclinicaltrials.eu/ctis-public/view/2023-510470-13-00